EU clinical trial 2023-509089-39-00: B8011006 - A Phase 3, Multinational, Randomized, Open-Label, Three Parallel-Arm Study of PF-06801591, an Anti-PD-1 antibody, in Combination With Bacillus Calmette-Guerin (BCG Induction With or Without BCG Maintenance) Versus BCG (Induction and Maintenance) in Participants With High-Risk, BCG-Naïve Non-Muscle Invasive Bladder Cancer or PF-06801591 as a Single Agent in Participants With BCG-Unresponsive NMIBC
Protocol code: B8011006
Sponsor: Pfizer Inc. (Pharmaceutical company). Phase: Therapeutic confirmatory (Phase III). Countries: Belgium (ongoing, recruitment ended), Italy (ongoing, recruitment ended), Spain (ongoing, recruitment ended), Germany (ongoing, recruitment ended), France (ongoing, recruitment ended), Poland (ongoing, recruitment ended).
Therapeutic area(s): Diseases [C] - Neoplasms [C04]
Gender: Female, Male. Age: 18-64 years, 65+ years. Enrolment: 313.
Status: Ongoing, recruitment ended. Start date (EU): 2020-07-01. Decision date: 2024-06-12. Results received: No. Last updated: 2026-07-28.
Decision dates by country: IT: 2024-06-17, PL: 2024-06-19, FR: 2024-06-18, BE: 2024-06-12, DE: 2024-06-14, ES: 2024-06-17

Condition(s): Non-Muscle Invasive Bladder Cancer
Product: Sasanlimab

Primary endpoint: Cohort A: EFS as assessed by the investigator., Cohorts B1 and B2: CR as assessed by the BICR. EFS as determined by the investigator
Endpoint(s): OS

Source: https://euclinicaltrials.eu/ctis-public/view/2023-509089-39-00